EU clinical trial 2024-517571-20-00: An Open-Label, Randomized Phase 3 Study to Evaluate Enfortumab Vedotin vs Chemotherapy in Subjects with Previously Treated Locally Advanced or Metastatic Urothelial Cancer (EV-301)
Protocol code: 7465-CL-0301
Sponsor: Astellas Pharma Global Development Inc. (Pharmaceutical company). Phase: Therapeutic confirmatory (Phase III). Countries: Portugal (ended), Spain (ended).
Therapeutic area(s): Diseases [C] - Neoplasms [C04]
Gender: Female, Male. Age: 18-64 years, 65+ years. Enrolment: 80.
Status: Ended. Start date (EU): 2018-09-07. End date (EU): 2025-11-27. End date: 2025-11-28. Decision date: 2024-10-24. Results received: No. Last updated: 2025-11-26.
Decision dates by country: PT: 2024-10-29, ES: 2024-10-24

Condition(s): Locally advanced or metastatic urothelial cancer
Product: enfortumab vedotin, VINFLUNINE, DOCETAXEL, PACLITAXEL

Primary endpoint: Overall survival
Endpoint(s): PFS1 by RECIST V1.1, ORR (CR + PR) by RECIST V1.1, DCR (CR + PR + SD) by RECIST V1.1, DOR by RECIST V1.1, Safety variables (e.g., AEs, laboratory tests, vital sign measurements, 12-lead ECG and ECOG PS), QOL and PRO parameters (QLQ-C30 and EQ-5D-5L)

Source: https://euclinicaltrials.eu/ctis-public/view/2024-517571-20-00